EU clinical trial 2024-520121-36-00: STEP-WISE COMBINATION OF OBINUTUZUMAB, VEMURAFENIB AND COBIMETINIB IN PATIENTS WITH HAIRY CELL LEUKEMIA (HCL) PREVIOUSLY TREATED WITH PURINE ANALOGS OR UNFIT FOR CHEMOTHERAPY: A PHASE-2, SINGLE-ARMS, ITALIAN, MULTICENTER STUDY (HCL-PG04)
Protocol code: HCL-PG04
Sponsor: Universita' Degli Studi Di Perugia (Educational Institution). Phase: Therapeutic exploratory (Phase II). Countries: Italy (ongoing, recruitment ended).
Therapeutic area(s): Diseases [C] - Neoplasms [C04]
Gender: Female, Male. Age: 18-64 years, 65+ years. Enrolment: 50.
Status: Ongoing, recruitment ended. Start date (EU): 2025-01-28. Decision date: 2025-01-28. Results received: No. Last updated: 2025-01-28.

Condition(s): The following categories of HCL patients needing anti-leukemic treatment are eligible for inclusion in this protocol: 1) Patients whose disease is refractory to therapy with purine analogues (no CR no PR, or relapse ≤1 year following treatment). 2) Patients who relapse early (≥1 year and ≤2 years) after the first course of a purine analogue (pentostatin or cladribine), or who relapse whenever after a second or later course. If the first relapse is accompanied by bone marrow hypoplasia (<20% hematopoietic cells on histological analysis), which would advise against chemotherapy with a purine analogue, the patient is eligible even if the relapse occurs >2 years after the first course. 4) Patients who: i) manifested severe side effects from a previous therapy with purine analogues (including, but not limited to, prolonged and profound myelosuppression and immunosuppression, infectious complications, renal failure, vasculitis; autoimmune hemolytic anemia); or ii) are deemed by the investigator medically unfit for chemotherapy with purine analogues (for example because of old age and/or significant comorbidities); or iii) firmly refuse to undergo chemotherapy (for example because they are Jehovah's witnesses and want to avoid any chemotherapy-induced need of blood product transfusions); or iv) have an active infection which would make chemotherapy with purine analogs risky; in this case patients enrolled in a cohort where obinutuzumab is planned (Cohort-1/Phase-A, Cohort-1/Phase-B and Cohort-3) are allowed to start vemurafenib with or without cobimetinib immediately, whereas obinutuzumab should be started only after the active infection has been controlled.
Product: Zelboraf 240 mg film-coated tablets, Gazyvaro 1,000 mg concentrate for solution for infusion., Cotellic 20 mg film-coated tablets

Primary endpoint: 1. The primary endpoint in each cohort is to meet or exceed a pre-determined rate of response (complete or overall response as specified later for each cohort) according to a per-protocol analysis. The rate of response will be also calculated according to the intention-to-treat analysis for informative purpose only, because this is a phase- 2 non-randomized trial primarily designed to test the anti-leukemic activity of the study drugs.
Endpoint(s): 1. To describe the type, incidence, grade and relationship to the study drugs of adverse events (AE) occurring in each cohort., 2. To describe separately in each cohort: the time to response; the relapse-free survival (or response duration); the treatment-free survival; the progression-free survival; the event-free survival; the disease-specific survival; the overall survival; the specific type of, and response to, other anti-leukemic treatments.

Source: https://euclinicaltrials.eu/ctis-public/view/2024-520121-36-00